EU clinical trial 2025-522834-30-01: Fibroblast markers to tackle fibrosis in immune-mediated inflammatory diseases
Sponsor: Amsterdam UMC Stichting (Patient organisation/association). Phase: Therapeutic exploratory (Phase II). Countries: Netherlands (ongoing, recruiting).
Therapeutic area(s): Diseases [C] - Skin and Connective Tissue Diseases [C17]; Diseases [C] - Respiratory Tract Diseases [C08]; Diseases [C] - Digestive System Diseases [C06]; Diseases [C] - Immune System Diseases [C20]
Gender: Female, Male. Age: 18-64 years, 65+ years. Enrolment: 60.
Status: Ongoing, recruiting. Start date (EU): 2026-07-24. Decision date: 2026-03-02. Results received: No. Last updated: 2026-06-29.

Condition(s): Systemic sclerosis (SSc), Idiopathic pulmonary fibrosis (IPF), Ulcerative colitis (UC), Fibrotic hypersensitivity pneumonitis (FHP), Crohn's disease (CD), Unclassifiable interstitial lung disease (uILD), Idiopathic inflammatory myopathy (IIM)
Product: 68Ga-FAPI-46

Primary endpoint: Detection of areas with enhanced 68Ga-FAPi uptake in organs of patients with IBD, CTD or ILD and correlation of imaging outcomes to cellular and serum FAP expression levels, Transcriptome and proteome analysis of tissue samples for FAP and other potential fibrotic biomarkers as well as regulators of upstream signaling pathways and immune cell markers.
Endpoint(s): Visual and semi-quantitative evaluation of the pharmacokinetics of 68GA-FAPi in patients with CTD and ILD., Optimization of the 68Ga-FAPi PET/CT scanning protocol for patients with CTD and ILD.

Source: https://euclinicaltrials.eu/ctis-public/view/2025-522834-30-01